EU clinical trial 2023-509215-81-00: Phase Ib/II multicohort trial of trabectedin, irinotecan, and low-dose radiation therapy in advanced/metastatic sarcomas.
Protocol code: Geis-75
Sponsor: Asoc Grupo Espanol De Investigacion En Sarcomas (Patient organisation/association). Phase: Therapeutic exploratory (Phase II). Countries: Spain (ongoing, recruiting).
Therapeutic area(s): Diseases [C] - Neoplasms [C04]
Gender: Female, Male. Age: 0-17 years, 18-64 years, 65+ years. Enrolment: 92.
Status: Ongoing, recruiting. Start date (EU): 2024-05-22. Decision date: 2024-05-22. Results received: No. Last updated: 2026-07-08.

Condition(s): Adult and young adult patients with diagnosis of advanced/metastatic soft tissue sarcoma, bone tumors (osteosarcoma, chondrosarcoma) and small round-cell sarcomas (Ewing’s sarcoma, rhabdomyosarcoma, desmoplastic small round-cell tumors and other small round cell sarcomas) with measurable disease.
Product: Irinotecán Hospira 20 mg/mL concentrado para solución para perfusión EFG., Yondelis 1 mg powder for concentrate for solution for infusion

Primary endpoint: Cohorts A, B and C: Overall response rate (ORR) in the irradiated nodules: ORR is defined as the number of subjects with a best overall response (BOR) of complete response (CR) or partial response (PR) only in the irradiated nodules divided by the number of response evaluable subjects (according to RECIST v1.1 criteria and based on central radiology review). This is considered a good surrogate for palliative relief., Cohort D: The RP2D will be determined by assessing adverse events according to CTCAE v5.0 and they will be used as a rule for changing dose levels according to the dose-limiting toxicities detailed in the protocol.
Endpoint(s): Cohorts A, B and C: Overall response rate (ORR) considering all the lesions: ORR is defined as the number of subjects with a best overall response (BOR) of complete response (CR) or partial response (PR) considering all the lesions divided by the number of response evaluable subjects (according to RECIST v1.1 criteria and based on central radiology review)., Cohorts A, B and C: Progression-free survival rate (PFSR) at 6 months considering all the lesions: Efficacy measured by the PFSR at 6 months according to RECIST v1.1 criteria based on central radiology review. PFSR at 6 months is defined as the percentage of patients who did not experience progression (considering all the lesions) or death due to any cause since the date of enrollment until month 6 after date of enrollment., Cohorts A, B and C: Median progression-free survival (mPFS): Efficacy measured by the mPFS according to RECIST v1.1 criteria based on central radiology review. mPFS is defined as the median of time in months between the date of enrollment and the date of progression (considering all the lesions) or death due to any cause., Cohorts A, B and C: Time to progression (TTP) of irradiated nodules: TTP is defined as the time in months between the date of enrollment and the date of progression of irradiated nodules (not including deaths) (according to RECIST v1.1 criteria and based on central radiology review)., Cohorts A, B and C: Overall survival (OS): OS is defined as the time in months between the date of enrollment and the date of death due to any cause. OS will be censored on the last date a subject was known to be alive., Cohorts A, B and C: Changes in pain: Variations in pain will be measured by the Brief Pain Inventory – Short Form (BPI-SF). Variations from baseline will be assessed on day 1 of every cycle (before trabectedin administration) until cycle 10 and then on day 1 every other cycle (cycle 12 day 1, cycle 14 day 1…)., Cohorts A, B and C: Changes in quality of life: Variations in quality of life will be measured by the QLQ-C30 EORTC v3.0 questionnaire. Variations in quality of life will be assessed at baseline (within 7 days with respect to enrollment), on day 1 of every cycle (before trabectedin administration) until cycle 10and then on day 1 every other cycle (cycle 12 day 1, cycle 14 day 1…)., Cohorts A, B and C: Safety profile: toxicity will be assessed considering adverse event type, incidence, severity, time of appearance, related causes, through physical explorations and laboratory tests. Toxicity will be graded and tabulated by using CTCAE v5.0., Cohort D: Overall response rate (ORR) in the irradiated nodules: ORR is defined as the number of subjects with a best overall response (BOR) of complete response (CR) or partial response (PR) only in the irradiated nodules divided by the number of response evaluable subjects (according to RECIST v1.1 criteria and based on central radiology review). This is considered a good surrogate for palliative relief., Cohort D: Overall response rate (ORR) considering all the lesions: ORR is defined as the number of subjects with a best overall response (BOR) of complete response (CR) or partial response (PR) considering all the lesions divided by the number of response evaluable subjects (according to RECIST v1.1 criteria and based on central radiology review)., Cohort D: Progression-free survival rate (PFSR) at 6 months considering all the lesions: Efficacy measured by the PFSR at 6 months according to RECIST v1.1 criteria based on central radiology review. PFSR at 6 months is defined as the percentage of patients who did not experience progression (considering all the lesions) or death due to any cause since the date of enrollment until month 6 after date of enrollment., Cohort D: Median progression-free survival (mPFS): Efficacy measured by the mPFS according to RECIST v1.1 criteria based on central radiology review. mPFS is defined as the median of time in months between the date of enrollment and the date of progression (considering all the lesions) or death due to any cause., Cohort D: Time to progression (TTP) of irradiated nodules: TTP is defined as the time in months between the date of enrollment and the date of progression of irradiated nodules (not including deaths) (according to RECIST v1.1 criteria and based on central radiology review)., Cohort D: Overall survival (OS): OS is defined as the time in months between the date of enrollment and the date of death due to any cause. OS will be censored on the last date a subject was known to be alive., Cohort D: Changes in pain: Variations in pain will be measured by the Brief Pain Inventory – Short Form (BPI-SF). Variations from baseline will be assessed on day 1 of every cycle (before trabectedin administration) until cycle 10 and then on day 1 every other cycle (cycle 12 day 1, cycle 14 day 1…)., Cohort D: Changes in quality of life: Variations in quality of life will be measured by the QLQ-C30 EORTC v3.0 questionnaire. Variations in quality of life will be assessed at baseline (within 7 days with respect to enrollment), on day 1 of every cycle (before trabectedin administration) until cycle 10and then on day 1 every other cycle (cycle 12 day 1, cycle 14 day 1…)., Cohort D: Safety profile: toxicity will be assessed considering adverse event type, incidence, severity, time of appearance, related causes, through physical explorations and laboratory tests. Toxicity will be graded and tabulated by using CTCAE v5.0.

Source: https://euclinicaltrials.eu/ctis-public/view/2023-509215-81-00